EU clinical trial 2025-524359-30-00: Tarlatamab Before and After Surgery for Recurrent High-Grade Glioma
Protocol code: VHIO25001
Sponsor: Vall D Hebron Institute Of Oncology (Laboratory/Research/Testing facility). Phase: Human Pharmacology (Phase I)- Other. Countries: Spain (authorised, recruitment pending).
Therapeutic area(s): Diseases [C] - Neoplasms [C04]; Diseases [C] - Nervous System Diseases [C10]
Gender: Female, Male. Age: 18-64 years, 65+ years. Enrolment: 10.
Status: Authorised, recruitment pending. Decision date: 2026-07-22. Results received: No. Last updated: 2026-07-22.

Condition(s): surgically resectable recurrent high-grade glioma

Source: https://euclinicaltrials.eu/ctis-public/view/2025-524359-30-00